EU clinical trial 2024-517966-40-00: A multicentre, randomized trial in adults with de novo Philadelphia-Chromosome positive acute lymphoblastic leukemia to assess the efficacy of ponatinib versus imatinib in combination with low-intensity chemotherapy, to compare end of therapy with indication for SCT versus TKI, blinatumomab and chemotherapy in optimal responders and to evaluate blinatumomab in suboptimal responders (GMALL-EVOLVE)
Sponsor: Goethe University Frankfurt (Educational Institution). Phase: Therapeutic exploratory (Phase II). Countries: Germany (ongoing, recruiting).
Therapeutic area(s): Diseases [C] - Hemic and Lymphatic Diseases [C15]
Gender: Female, Male. Age: 18-64 years. Enrolment: 208.
Status: Ongoing, recruiting. Start date (EU): 2023-07-13. Decision date: 2024-11-08. Results received: No. Last updated: 2026-05-21.

Condition(s): Acute lymphoblastic leukemia (ALL), de novo, Ph/BCR::ABL1 positive (Ph+)
Product: Iclusig 45 mg film-coated tablets, IMATINIB, IMATINIB, BLINCYTO 38.5 micrograms powder for concentrate and solution for solution for infusion.

Primary endpoint: Probability of overall survival at 2,3 and 4 years from randomization I in patients with mo- lecular remission after consolidation 1 comparing a combination treatment of TKI, Blina- tumomab and chemotherapy versus EOT with indication for SCT
Endpoint(s): Rate of molecular complete remission at week 11 after consolidation with chemotherapy in combination with Ponatinb versus Imatinib

Source: https://euclinicaltrials.eu/ctis-public/view/2024-517966-40-00